EU clinical trial 2024-512735-72-00: Prospective pilot trial to address the feasibility and safety of treatment with oral Zinc in GNAO1 associated disorders (ZINCGNAO1)
Protocol code: Uni-Koeln-5275
Sponsor: University Of Cologne (Educational Institution). Phase: Therapeutic exploratory (Phase II). Countries: Germany (ended).
Therapeutic area(s): Diseases [C] - Nervous System Diseases [C10]; Diseases [C] - Congenital, Hereditary, and Neonatal Diseases and Abnormalities [C16]
Gender: Female, Male. Age: 0-17 years, 18-64 years. Enrolment: 12.
Status: Ended. Start date (EU): 2024-07-30. End date (EU): 2025-08-04. Decision date: 2024-06-03. Results received: Yes. Last updated: 2026-01-19.

Condition(s): GNAO1 associated disorders
Product: Wilzin 50 mg hard capsules, Wilzin 25 mg hard capsules

Primary endpoint: The feasibility is measured by the actual days that zinc was taken in the right dosage. If the IMP was taken in the scheduled dosage at least on 80% of the days it is assumed to be feasible., The safety is measured by regular evaluation of the AEs
Endpoint(s): Level of Motor-Skills: measured by the Gross-Motor-Function measure-66 (GMFM-66) at visit 0, 2 and 3., Quality of Life: (1) as reported by the Caregiver Priorities & Child Health Index of Life with Disabilities (CP-Child) Questionnaire for the caregivers (Visit 0, 2 and 3) and (2) as reported in the Canadian Occupational Performance Measure (COPM) (Visit 0 and 3)., The level of dystonia is measured by the Burke-Fahn-Marsden Dystonia Rating scale (BFMDRS) at visit 0, 2 and 3., General behaviour including level of alertness and better sleep is recorded by the parents in a daily logbook that has to been filled out during the trial, Frequency, time and duration of seizures is also recorded by the parents in a logbook, Serum levels of zinc at visit 0, 2, 3 to measure the efficacy of oral zinc administration, Serum level of ferritin and copper at visit 0, 2, 3 to detect potential deficiencies, caused by reduced uptake because of the regular zinc administration, Analyzation of the microbiome in the stool by the collaborating laboratory to detect any changes respect to the GNAO1 affected cells of the intestinal, Level of dyskinesia measured by Abnormal involuntary movement scale (AIMS) at visit 0, 2 and 3 and a Movement log for parents, As far as feasible, depending on patient numbers, the individual results will be put in correlation to the specific variant of the patient to see if the outcome is influenced by the specific variant

Source: https://euclinicaltrials.eu/ctis-public/view/2024-512735-72-00